EU clinical trial 2025-522605-37-00: Early-stage clinical trial investigating the individual and combined effect of two drugs, senicapoc and perampanel, as part of the treatment for newly diagnosed glioblastoma, which is an aggressive brain tumor
Sponsor: Region Midtjylland (Hospital/Clinic/Other health care facility). Phase: Human Pharmacology (Phase I)- Other. Countries: Denmark (ongoing, recruiting).
Therapeutic area(s): Diseases [C] - Neoplasms [C04]; Phenomena and Processes [G] - Genetic Phenomena [G05]; Diseases [C] - Nervous System Diseases [C10]
Gender: Female, Male. Age: 18-64 years, 65+ years. Enrolment: 36.
Status: Ongoing, recruiting. Start date (EU): 2026-03-01. Decision date: 2025-10-14. Results received: No. Last updated: 2026-07-24.

Condition(s): Glioblastoma

Source: https://euclinicaltrials.eu/ctis-public/view/2025-522605-37-00